EU clinical trial 2025-523555-66-00: A Phase 3, Randomized, Double-Blind, Active-Control Study of Pelabresib (DAK539) and Ruxolitinib vs. Placebo and Ruxolitinib in Adult Patients with Myelofibrosis who are JAK inhibitor naive
Protocol code: CDAK539A12303
Sponsor: Novartis Pharma AG (Pharmaceutical company). Phase: Therapeutic confirmatory (Phase III). Countries: Belgium (authorised, recruitment pending), Germany (authorised, recruitment pending), Austria (authorised, recruitment pending), Poland (authorised, recruitment pending), Spain (authorised, recruitment pending), Italy (authorised, recruitment pending), Netherlands (authorised, recruitment pending), Czechia (authorised, recruitment pending), France (authorised, recruitment pending).
Therapeutic area(s): Diseases [C] - Neoplasms [C04]
Gender: Female, Male. Age: 18-64 years, 65+ years. Enrolment: 173.
Status: Authorised, recruitment pending. Decision date: 2026-05-29. Results received: No. Last updated: 2026-06-03.
Decision dates by country: AT: 2026-06-01, BE: 2026-05-29, CZ: 2026-05-29, FR: 2026-06-03, DE: 2026-06-01, IT: 2026-05-29, ES: 2026-06-01, NL: 2026-06-02, PL: 2026-06-02

Condition(s): Myelofibrosis
Product: Jakavi 5 mg tablets, DAK539, Placebo to DAK539, Jakavi 5 mg tablets, Jakavi 10 mg tablets, Jakavi 15 mg tablets, Jakavi 5 mg tablets, Jakavi 15 mg tablets, Jakavi 20 mg tablets, Jakavi 10 mg tablets, Jakavi 20 mg tablets, DAK539

Primary endpoint: Co-primary endpoints: • Spleen response defined as achieving ≥ 35% reduction in spleen volume (SVR35) from baseline to Week 24 as measured by MRI (or CT scan) and assessed by central radiology read • Absolute change from baseline in total symptom score (TSS) at Week 24 as measured by MFSAF v4.0
Endpoint(s): Spleen response defined as achieving ≥ 35% reduction in spleen volume (SVR35) from baseline to Week 12, Week 36, Week 48 and thereafter, as measured by MRI (or CT scan) • Absolute change from baseline and percentage change from baseline in spleen volume over time • Time to first SVR35 response • Duration of response defined as the time from first SVR35 response to loss of response for any participant who reaches SVR35 at any time, Symptom response defined as achieving≥ 50%reduction in TSS50 from baseline to Week 24 as measured by the MFSAF v4.0 Symptom response defined as achieving≥ 50%reduction in TSS50 from baseline to Week12,36,48 and thereafter as measured by theMFSAFv4.0 Absolute change from baseline and percentage change from baseline in TSS over time Time to first TSS50 response Duration of TSS50 response defined as the time from first TSS50 response to loss of response for any participant who reaches TSS50 at any, Dual response defined as achieving both ≥ 35% reduction in spleen volume (SVR35) and ≥ 50% reduction in total symptom score (TSS50) from baseline to Week 12, 24, 36, 48 and thereafter with SVR measured by MRI (or CT scan) and assessed by central radiology read and TSS measured by MFSAF v4.0, Hemoglobin response defined as a ≥1.5 g/dL average increase in hemoglobin from baseline in any 12-week mean hemoglobin concentration Hemoglobin change from baseline Anemia response (major response, minor response, stable anemia, progressive anemia) as per proposed 2024 IWG-ELN criteria in participants with transfusion dependent anemia and non-transfusion dependent anemia, OS defined as the time from randomization until death from any cause, PFS defined as the time from randomization until documented progression, or death from any cause whichever comes first, LFS defined as the time from randomization until leukemic transformation, or death from any cause whichever comes first, Exposure-adjusted incidence rate (EAIR) of participants with leukemic transformation, Treatment-emergent AEs of all grades and SAEs, Pelabresib plasma concentrations at specific time points, Pelabresib plasma PK parameters (Cmax, Tmax, AUCtau), Change from baseline over time in fatigue as measured by PROMIS SF v1.0 Fatigue 7a Change from baseline over time in overall QOL and functional scales as measured by the EORTC QLQ-C30

Source: https://euclinicaltrials.eu/ctis-public/view/2025-523555-66-00